EU clinical trial 2024-518991-30-00: Digital monitoring of self-reported symptoms by patients treated with Cabozantinib plus Nivolumab for advanced clear-cell renal carcinoma: The CANIQOL multicentre study
Protocol code: CANIQOL
Sponsor: Centre Francois Baclesse (Hospital/Clinic/Other health care facility). Phase: Therapeutic use (Phase IV). Countries: France (ongoing, recruiting).
Therapeutic area(s): Diseases [C] - Neoplasms [C04]; Analytical, Diagnostic and Therapeutic Techniques and Equipment [E] - Therapeutics [E02]
Gender: Female, Male. Age: 18-64 years, 65+ years. Enrolment: 83.
Status: Ongoing, recruiting. Start date (EU): 2025-07-17. Decision date: 2025-06-04. Results received: No. Last updated: 2026-07-10.

Condition(s): kidney cancer
Product: CABOMETYX 40 mg film-coated tablets, OPDIVO 10 mg/mL concentrate for solution for infusion.

Primary endpoint: The primary endpoint is the adjustment of treatments management including any unplanned action guided by weekly digital monitoring of PRO-CTCAEs: anticipated consultation, anticipated phone follow-up, anticipated advices, treatment discontinuation, hospitalization within the first 3 months of the combined treatment

Source: https://euclinicaltrials.eu/ctis-public/view/2024-518991-30-00